EU clinical trial 2025-522595-87-00: A Phase 1/2, Multicenter, Open-Label, Multi-Cohort, First-in Human Trial of DS3790a, a DXd-ADC targeting CD37, for Hematological Malignancies.
Protocol code: DS3790-076
Sponsor: Daiichi Sankyo Inc. (Pharmaceutical company). Phase: Phase I and Phase II (Integrated)- First administration to humans. Countries: France (ongoing, recruiting), Italy (authorised, recruiting).
Therapeutic area(s): Diseases [C] - Neoplasms [C04]
Gender: Female, Male. Age: 18-64 years, 65+ years. Enrolment: 40.
Start date (EU): 2026-04-21. Decision date: 2026-02-16. Results received: No. Last updated: 2026-05-18.
Decision dates by country: IT: 2026-02-16, FR: 2026-02-16

Condition(s): Hematological Malignancies
Product: EPCORITAMAB, RITUXIMAB

Primary endpoint: 1. Number of Participants Reporting Dose-limiting Toxicities, Treatment-emergent Adverse Events, Serious Adverse Events, Adverse Events of Special Interest, and Deaths in Participants With Hematological Malignancies. Adverse events (AEs) will be graded using NCI-CTCAE version 5.0., 2. Complete Response in Participants With Hematological Malignancies by Blinded Independent Central Review (Cohort A Randomization Optimization Phase, Cohort A Phase 2). Complete Response (CR) is defined as participants with CR as measured by Blinded Independent Central Review assessment., 3. Complete Response in Participants With Hematological Malignancies by Investigator Assessment (Cohort B Randomization Optimization Phase). Complete Response (CR) is defined as participants with CR as measured by investigator assessment.

Source: https://euclinicaltrials.eu/ctis-public/view/2025-522595-87-00